EU clinical trial 2023-507512-12-00: A Multiple-Ascending-Dose Study of MK-4318 in Healthy Participants
Protocol code: MK-4318-002
Sponsor: Merck Sharp & Dohme LLC (Pharmaceutical company). Phase: Human Pharmacology (Phase I)- Other. Countries: Belgium (ended).
Therapeutic area(s): Diseases [C] - Nervous System Diseases [C10]
Gender: Female, Male. Age: 18-64 years. Enrolment: 32.
Status: Ended. Start date (EU): 2023-11-16. End date (EU): 2024-03-20. End date: 2024-03-21. Decision date: 2023-11-09. Results received: No. Last updated: 2023-12-07.

Condition(s): Pain

Source: https://euclinicaltrials.eu/ctis-public/view/2023-507512-12-00